EU clinical trial 2025-524279-22-00: Exploratory study on the effect of Rimonabant on hand function in patients with spinal cord injury (RIMOHANDOPEN)
Protocol code: RIMOHANDOPEN
Sponsor: Sinfatin S.L. (Pharmaceutical company). Phase: Phase I and Phase II (Integrated)- Other. Countries: Spain (ongoing, recruiting).
Therapeutic area(s): Phenomena and Processes [G] - Musculoskeletal and Neural Physiological Phenomena [G11]; Diseases [C] - Nervous System Diseases [C10]
Gender: Female, Male. Age: 18-64 years, 65+ years. Enrolment: 8.
Status: Ongoing, recruiting. Start date (EU): 2026-05-22. Decision date: 2026-04-22. Results received: No. Last updated: 2026-05-28.

Condition(s): Spinal cord injury
Product: Rimonabant 2,5 mg tablets

Primary endpoint: The primary endpoint is defined as the change in the total GRASSP score, or in any of its three dimensions, between baseline and the end of rimonabant treatment.
Endpoint(s): 6-Minute Walk Test (6MWT): measures the distance a participant can walk in six minutes, providing an index to measure fatigue, endurance and functional walking capacity, 10-Meter Walk Test (10MWT): measures the time taken to walk 10 meters at a comfortable or maximal pace, used to assess motor function through walking speed, fatigue and endurance, Berg Balance Scale (BBS): evaluates static and dynamic balance through 14 functional tasks, providing a quantitative assessment of fall risk and postural control, Walking Index for Spinal Cord Injury II (WISCI-II): assesses walking ability based on the level of assistance, use of assistive devices and need for support, yielding a score reflecting functional ambulation capacity., Finger Tapping Test (FTT): measures motor speed and coordination by recording the number of finger taps within a set time period, Box and Block Test (BBT): assesses gross manual dexterity by counting the number of blocks transferred from one compartment to another in 60 seconds, Nine-Hole Peg Test (9HPT): measures fine manual dexterity by timing how long it takes to place and remove nine pegs from a boardNine-Hole Peg Test (9HPT): measures fine manual dexterity by timing how long it takes to place and remove nine pegs from a board, Dynamometry: measures handgrip strength by recording the maximum force exerted during a grip using a handheld dynamometer., Upper Extremity Motor Score (UEMS): evaluates motor strength of five key upper limb muscles bilaterally. This data is obtained from the ISNCSCI scale, Functional Reach Test (FRT): assesses upper limb functional reach and dynamic balance by measuring the maximum distance an individual can reach forward without losing stability, Borg CR10 Scale: assesses perceived exertional fatigue immediately after the 6MWT and FTT, providing a subjective measure of effort intensity, Visual Analogue Scale for Fatigue (VAS-F): assesses perceived fatigue intensity by having participants rate their level of fatigue after FTT, Fatigue Severity Scale (FSS): evaluates fatigue severity over the previous week. Scores ≥ 4 indicate clinically significant fatigue, Multidimensional Fatigue Inventory (MFI-20): measures five dimensions of fatigue, offering a comprehensive assessment of fatigue impact, Breathing test: test designed to evaluate the respiratory function and lung capacity of the participant., Oximetry: non-invasively measures blood oxygen saturation and heart rate, providing a quick indicator of the participant's respiratory status, Heart rate: non-invasive measurement used to monitor cardiovascular response and detect potential abnormalities in heart function., Blood pressure (systolic and diastolic): non-invasive assessment providing key information on vascular resistance and overall cardiovascular health., International Standards for Neurological Classification of Spinal Cord Injury (ISNCSCI): determines the neurological level and completeness of spinal cord injury through systematic assessment of motor and sensory function, Transcranial magnetic stimulation (TMS): evaluate corticospinal excitability and motor pathway integrity registering motor evoked potentials (MEPs)., Somatosensory evoked potentials (SEPs) via electrical stimulation: assess sensory pathway conduction and integrity by recording cortical responses to peripheral nerve electrical stimulation., Spinal Cord Independence Measure (SCIM-III): measures functional independence in activities of daily living, mobility, and sphincter management, providing an index of overall functional recovery., Medical Outcomes Study Sleep Scale (MOS-SS): assesses multiple aspects of sleep, including quality, disturbances, somnolence, and adequacy, over the previous four weeks., Patient Global Impression of Change (PGIC): captures the patient’s subjective perception of overall improvement or deterioration since the beginning of the study., Recording and assessment of adverse events (AEs) occurring during treatment, serious adverse events (SAEs), and adverse events of special interest (AESIs)., Clinically significant changes in physical examination, biochemical parameters, vital signs., Clinically significant changes in subjective pain perception, assessed using the Visual Analogue Scale (VAS-P)., Clinically significant changes in the level of muscle spasticity, assessed using the Modified Ashworth Scale (MAS)., Clinically significant changes in the frequency of muscle spasms, assessed using the Penn Spasm Frequency Scale (PSFS)., Clinically significant changes in mood, specifically depression and anxiety, assessed using the Beck Depression Inventory-II (BDI-II) and the Hospital Anxiety and Depression Scale (HADS)., Suicide risk, assessed using C-SSRS.

Source: https://euclinicaltrials.eu/ctis-public/view/2025-524279-22-00